EU clinical trial 2024-515608-38-00: A Phase I study to evaluate the safety and dosimetry of 68Ga-OncoACP3 in patients with prostate cancer
Protocol code: PH-ACP3GA-01/24
Sponsor: Philogen S.p.A. (Pharmaceutical company). Phase: Human Pharmacology (Phase I)- First administration to humans. Countries: Italy (ended).
Therapeutic area(s): Diseases [C] - Neoplasms [C04]
Gender: Male. Age: 18-64 years, 65+ years. Enrolment: 20.
Status: Ended. Start date (EU): 2025-03-19. End date (EU): 2025-10-03. Decision date: 2024-11-27. Results received: No. Last updated: 2025-11-18.

Condition(s): Patients with prostate cancer with: -suspected metastasis who are candidates for initial definitive therapy; -suspected recurrence based on elevated serum prostate-specific antigen (PSA) level (i.e., a progressive and confirmed serum PSA level > 0.2 ng/mL); -metastatic disease who might be candidates for treatment with 177Lu-labelled PSMA ligands

Source: https://euclinicaltrials.eu/ctis-public/view/2024-515608-38-00